EU clinical trial 2024-515424-36-00: A Randomized, Open-label, Controlled, Phase 2 Study of Pevonedistat, Venetoclax, and Azacitidine Versus Venetoclax Plus Azacitidine in Adults With Newly Diagnosed Acute Myeloid Leukemia Who Are Unfit for Intensive Chemotherapy Triple Combination of Pevonedistat and Venetoclax Plus Azacitidine in Adults With Acute Myeloid Leukemia Who Are Unfit for Intensive Chemotherapy
Protocol code: Pevonedistat-2002
Sponsor: Takeda Development Center Americas Inc. (Pharmaceutical company). Phase: Therapeutic exploratory (Phase II). Countries: Italy (ended), Poland (ended).
Therapeutic area(s): Diseases [C] - Neoplasms [C04]
Gender: Female, Male. Age: 18-64 years, 65+ years. Enrolment: 2.
Status: Ended. Start date (EU): 2020-10-15. End date (EU): 2025-10-06. End date: 2025-10-07. Decision date: 2024-10-09. Results received: Yes. Last updated: 2025-06-24.
Decision dates by country: IT: 2024-10-14, PL: 2024-10-09

Condition(s): Acute Myeloid Leukemia
Product: Vidaza 25 mg/ml powder for suspension for injection, Azacitidin STADA 25 mg/ml Pulver zur Herstellung einer Injektionssuspension, Venclyxto 10 mg film-coated tablets, Venclyxto 50 mg film-coated tablets, Azacitidine Mylan 25 mg/mL powder for suspension for injection, Azacitidine Mylan 25 mg/mL powder for suspension for injection, pevonedistat hydrochloride, Venclyxto 100 mg film-coated tablets

Primary endpoint: The primary endpoint of the study is EFS defined as failure to achieve CR/CRi, relapse from CR/CRi, or death.
Endpoint(s): The key secondary endpoint is OS (Overall Survival) defined as the time from randomization to death from any cause., 30- and 60-day mortality rates defined as the proportion of patients who survive at most 30/60 days from the first dose of study drug(s)., Disease response rates as evaluated by IRC: – CR rate – CCR (CR + CRi) rate – ORR (CR + CRi + PR) rate – CR + CRh rate – Leukemia response rate (CR + CRi + PR + MLFS [marrow CR]), Duration of CR and CRi. • Time to first CR, CRi, and PR. • Pevonedistat plasma concentration time.

Source: https://euclinicaltrials.eu/ctis-public/view/2024-515424-36-00